EU clinical trial 2023-505430-10-00: The clinical value of tau PET in the memory clinic (TAP-TAU)
Sponsor: Amsterdam UMC (Hospital/Clinic/Other health care facility). Phase: Phase II and Phase III (Integrated). Countries: Netherlands (ongoing, recruiting).
Therapeutic area(s): Diseases [C] - Nervous System Diseases [C10]
Gender: Female, Male. Age: 65+ years. Enrolment: 360.
Status: Ongoing, recruiting. Start date (EU): 2024-10-10. Decision date: 2023-12-21. Results received: No. Last updated: 2026-03-18.

Condition(s): Mild cognitive impairment and dementia
Product: Flortaucipir

Primary endpoint: Pre- vs. post-tau PET change in diagnosis (diagnostic categories: AD, non-AD with specification of suspected underlying pathology, mixed AD/non-AD pathology) and comparison with a control group after a year, Pre- vs. post-tau PET change in confidence of the clinician in the etiological diagnosis (continuous scale ranging from 0-100%, baseline <85% required) and comparison with a control group after a year., Pre- vs. post-tau PET change in patient management (increase or reduction in ancillary investigations, initiation or withdrawal of medication, initiation or withdrawal of care; we will also assess whether it would influence hypothetical prescription of disease modifying treatment of AD) and comparison with a control group after a year., Pre- vs. post-tau PET change in patient wellbeing (measures of anxiety and uncertainty) and behavioural intentions and post-tau PET perceptions, experiences and understanding of tau PET.
Endpoint(s): Performance of tau PET compared to novel blood-based biomarkers and artificial intelligence (AI) based classifiers.

Source: https://euclinicaltrials.eu/ctis-public/view/2023-505430-10-00